EU clinical trial 2025-521161-27-00: CBD-SIB - Efficacy of cannabidiol in the management of Self-Injurious Behavior in children and adolescents with severe neurodevelopmental disorders
Protocol code: APHP240090
Sponsor: Assistance Publique Hopitaux De Paris (Hospital/Clinic/Other health care facility). Phase: Therapeutic exploratory (Phase II). Countries: France (authorised, recruitment pending).
Therapeutic area(s): Psychiatry and Psychology [F] - Behavior and Behavior Mechanisms [F01]
Gender: Female, Male. Age: 0-17 years. Enrolment: 21.
Status: Authorised, recruitment pending. Decision date: 2025-10-07. Results received: No. Last updated: 2026-04-28.

Condition(s): Children and adolescents with severe neurodevelopmental disorders
Product: Epidyolex 100 mg/ml oral solution

Primary endpoint: Cannabidiol will be considered effective at V8 D56 in clinically significant reductions in the frequency of self-injuries if the frequency score on the “Self-Injurious Behavior” subdomain of the BPI-01 is reduced by 30% or more at visit V8 D56 compared to visit V2 D0.
Endpoint(s): Cannabidiol will be considered effective at V6 D31 to clinically significantly reduce the frequency of self-injuries if the frequency score in the BPI-01 “Self-injurious Behavior” subdomain is reduced by 30% or more at visit V6 D31 compared to visit V2 D0., efficacy of the treatment assessed by the change in percentage scores between visit V2 D0 and visits V6 D31 and V8 D56: in the BPI-01 “Self-injurious behavior” subdomain; “Stereotyped behaviors” subdomain;“Aggressive/Destructive Behaviors” subdomain;- GED-DI score;- QI-Disability score;- Parental Stress Scale (PSS) score., Serious and non-serious clinical adverse events, in particular: diarrhea, vomiting, decreased appetite, weight loss, drowsiness, asthenia, fever, increased transaminases or total bilirubin, decreased hemoglobin and hematocrit, increased creatinine., Correlation between the change in the frequency of self-injuries (frequency score in the “Self-injurious behavior” subdomain of the BPI-01) between V2 D0 and V6 D31 and V8 D56 and the change in the frequency of non-verbal manifestations of pain (GED-DI score) between V2 D0 and V6 D31 and V8 D56

Source: https://euclinicaltrials.eu/ctis-public/view/2025-521161-27-00